EU clinical trial 2024-515943-44-00: IFCT-1802 SAVIMMUNE A phase II single-arm trial evaluating safety and efficacy of Durvalumab in ECOG Performance Status 2-3, treatment-naive, patients with stage IV Non-Small Cell Lung Cancer (NSCLC) and high PD-L1 tumor expression
Protocol code: IFCT-1802
Sponsor: Intergroupe Francophone De Cancerologie Thoracique (Patient organisation/association). Phase: Therapeutic exploratory (Phase II). Countries: France (ended).
Therapeutic area(s): Diseases [C] - Neoplasms [C04]
Gender: Female, Male. Age: 18-64 years, 65+ years. Enrolment: 50.
Status: Ended. Start date (EU): 2020-10-14. End date (EU): 2025-09-26. Decision date: 2024-08-14. Results received: No. Last updated: 2025-10-03.

Condition(s): Non small cell lung cancer, Poor general status
Product: IMFINZI 50 mg/mL concentrate for solution for infusion.

Primary endpoint: Percentage of patients experiencing Grade 3-5 TRAEs at 8 weeks of durvalumab
Endpoint(s): Safety analysis : The maximum grade or adverse event will be summarized by frequency and proportion of total patients, by system organ class, Disease Control Rate at 8 weeks (percentage of patients with objective response or stable disease according to RECISTS 1.1 in the intent to treat population)., Objective Response Rate at 8 weeks according to RECIST 1.1 in the intent to treat population., PFS from the date of durvalumab initiation to progression date or death; PFS curves, PFS medians with 95% CIs, and PFS rates at 6 and 12 months with 95% CIs will be estimated using Kaplan-Meier methodology., OS from the date of durvalumab initiation to the date of death. OS curves, OFS medians with 95% CIs, and OFS rates at 6 and 12 months with 95% CIs will be estimated using Kaplan-Meier methodology., Performance status improvement rate, defined as the proportion of per-protocol patients whose PS was improved from baseline during durvalumab treatment., Quality of Life using EORTC QLQ-C30/QLQ-LC13 and EQ-5D questionnaires, and time until definitive HRQoL score deterioration (TUDD)., Centrally-assessed PD-L1 tumor expression : prognostic and predictive value using SP263 antibodies

Source: https://euclinicaltrials.eu/ctis-public/view/2024-515943-44-00